EU clinical trial 2024-513401-31-00: Systematic Adjunction of Vasopressine in hyperkinetic Septic Shock patients: a prospective, randomized, double blind study.
Protocol code: RCAPHM23_0465
Sponsor: Centre Hospitalier Regional De Marseille (Hospital/Clinic/Other health care facility). Phase: Therapeutic confirmatory (Phase III). Countries: France (ongoing, recruiting).
Therapeutic area(s): Diseases [C] - Immune System Diseases [C20]
Gender: Female, Male. Age: 18-64 years, 65+ years. Enrolment: 120.
Status: Ongoing, recruiting. Start date (EU): 2026-03-24. Decision date: 2025-04-22. Results received: No. Last updated: 2026-04-16.

Condition(s): Septic shock
Product: Reverpleg 40 U.I./2 ml solution à diluer pour perfusion, SODIUM CHLORIDE

Primary endpoint: Difference in SOFA score 48 hours after drug administration between the 2 groups
Endpoint(s): SOFA score at D5, All-cause mortality in ICU (date of death) and all-cause mortality at D28 (date of death), Plasma lactatemia clearance between introduction of experimental drug (H0) and H24 and H48, K-DIGO classification at D28 for severity, Use of extrarenal purification at D28 (yes/no), number of days alive without extrarenal purification at D28, Number of days alive without mechanical ventilation at D28, Maximum dose of noradrenaline during the first 5 days of inclusion defined as the maximum dose of noradrenaline infusion, Number of days alive without noradrenaline infusion at D28, Occurrence of myocardial ischemia defined as electrocardiogram (ECG) change with ST-segment elevation associated with >100% rise in plasma ultrasensitive troponin concentration, between inclusion and D28, Occurrence of cardiogenic shock defined as a left ventricular ejection fraction below 30% and the need to introduce a positive inotropic drug, between inclusion and D28, Occurrence of mesenteric ischemia defined as the occurrence of an intestinal vascular disorder requiring surgical management (vascular bypass or stent, digestive resection), between inclusion and D28, Occurrence of digital ischemia defined as clinical skin necrosis of the extremities of the upper and lower limbs, between inclusion and D28, Occurence of atrial fibrillation defined as irregular tachycardia with fine QRS of atrial origin, between inclusion and D28, Occurrence of a thromboembolic event defined by the presence of deep vein thrombosis or pulmonary embolism, between inclusion and D28

Source: https://euclinicaltrials.eu/ctis-public/view/2024-513401-31-00